EU clinical trial 2025-524635-39-00: An Open Label, Single Arm, Phase I/II Clinical Study of Autologous CD4+ T-Cells Edited Ex-Vivo at the CD40LG Locus by CRISPR/Cas9 and IDLV-based vector in Patients with X-linked Hyper IgM Syndrome Type 1 (HIGM1)
Sponsor: Fondazione Telethon Ets, San Raffaele Hospital (Patient organisation/association, Hospital/Clinic/Other health care facility). Phase: Phase I and Phase II (Integrated)- First administration to humans. Countries: Italy (authorised, recruitment pending).
Therapeutic area(s): Phenomena and Processes [G] - Genetic Phenomena [G05]; Diseases [C] - Immune System Diseases [C20]
Gender: Male. Age: 0-17 years, 18-64 years, 65+ years. Enrolment: 4.
Status: Authorised, recruitment pending. Decision date: 2026-05-20. Results received: No. Last updated: 2026-05-20.

Condition(s): X-linked immunodeficiency with hyper-IgM type 1 (HIGM1)
Product: Rabipur Polvere e solvente per soluzione iniettabile in siringa preriempita. Vaccino rabico (inattivato)., TICOVAC 0,25 ml per uso pediatrico Sospensione iniettabile in una siringa preriempita Vaccino (virus intero, inattivato) contro l'encefalite da zecca, AUTOLOGOUS PERIPHERAL BLOOD-DERIVED CD4+ T-CELLS CRISPR-EDITED AT THE CD40LG LOCUS, Infanrix hexa, Powder and suspension for suspension for injection. Diphtheria (D), tetanus (T), pertussis (acellular, component) (Pa), hepatitis B (rDNA) (HBV), poliomyelitis (inactivated) (IPV) and Haemophilus influenzae type b (Hib) conjugate vaccine (adsorbed)., TICOVAC 0,5 ml Sospensione iniettabile in una siringa preriempita Vaccino (virus intero, inattivato) contro l’encefalite da zecca

Primary endpoint: Proportion of patients experiencing dose-limiting toxicities (DLTs) after each drug product (DP) dose
Endpoint(s): Occurrence of: - Adverse events (AEs) - Serious adverse events (SAEs)Adverse events of special interest (AESIs) - DP-related AEs - Immune reconstitution inflammatory Syndrome (IRIS) (number, grading and proportion of patients experiencing IRIS) evaluated at 28 days after each dose, 6 months, 1 year and 2 years after treatment, Proportion of patients receiving the boost DP dose, Overall survival at 6 months, 1 year and 2 years after treatment, Incidence rate, duration and proportion of days with moderate-severe infection in the 2 years preceding and in the 2 years after treatment, evaluated in consecutive 6- month time windows (6 months, 1 year, 1.5 years and 2 years)

Source: https://euclinicaltrials.eu/ctis-public/view/2025-524635-39-00